EU clinical trial 2023-508838-33-00: A phase III, multi-center, open-label, randomized study of oral asciminib versus Investigator selected TKI in patients with newly diagnosed Philadelphia Chromosome Positive Chronic Myelogenous Leukemia in Chronic Phase
Protocol code: CABL001J12301
Sponsor: Novartis Pharma AG (Pharmaceutical company). Phase: Therapeutic confirmatory (Phase III). Countries: Bulgaria (ongoing, recruitment ended), Austria (ongoing, recruitment ended), Czechia (ongoing, recruitment ended), Portugal (ongoing, recruitment ended), Hungary (ongoing, recruitment ended), Norway (ongoing, recruitment ended), Denmark (ongoing, recruitment ended), Sweden (ongoing, recruitment ended), Belgium (ongoing, recruitment ended), Finland (ongoing, recruitment ended), Spain (ongoing, recruitment ended), France (ongoing, recruitment ended), Italy (ongoing, recruitment ended), Slovakia (ongoing, recruitment ended), Germany (ongoing, recruitment ended).
Therapeutic area(s): Diseases [C] - Neoplasms [C04]
Gender: Female, Male. Age: 18-64 years, 65+ years. Enrolment: 159.
Status: Ongoing, recruitment ended. Start date (EU): 2021-10-06. Decision date: 2024-05-13. Results received: No. Last updated: 2026-07-30.
Decision dates by country: HU: 2024-05-15, FI: 2024-05-15, DK: 2024-05-14, CZ: 2024-05-15, PT: 2024-05-13, IT: 2024-05-20, DE: 2024-05-15, AT: 2024-05-21, SK: 2024-05-13, BE: 2024-05-15, NO: 2024-05-14, BG: 2024-05-20, FR: 2024-05-16, SE: 2024-05-14, ES: 2024-05-17

Condition(s): Chronic Myeloid Leukemia
Product: DASATINIB, IMATINIB, DASATINIB, DASATINIB, DASATINIB, NILOTINIB, BOSUTINIB, BOSUTINIB, DASATINIB, DASATINIB, IMATINIB, NILOTINIB, ASCIMINIB HYDROCHLORIDE, IMATINIB

Primary endpoint: Major Molecular Response (MMR) at Week 48 (Yes/No)
Endpoint(s): Major Molecular Response (MMR) at Week 96 (Yes/No), Major Molecular response (MMR) at Week 96 (Yes/No)

Source: https://euclinicaltrials.eu/ctis-public/view/2023-508838-33-00